EU clinical trial 2024-514744-91-00: A Phase 1, Randomized, Double-Blind, Placebo-Controlled, Multiple Ascending Dose Study to Assess the Safety, Tolerability, and Pharmacokinetics of ATX304
Protocol code: ATX-304-02
Sponsor: Betagenon AB (Pharmaceutical company). Phase: Human Pharmacology (Phase I)- Other. Countries: Germany (ongoing, recruiting).
Therapeutic area(s): Diseases [C] - Cardiovascular Diseases [C14]
Gender: Female, Male. Age: 18-64 years. Enrolment: 64.
Status: Ongoing, recruiting. Start date (EU): 2026-08-03. Decision date: 2024-09-02. Results received: No. Last updated: 2026-07-30.

Condition(s): Obesity/overweight (healthy subjects)

Source: https://euclinicaltrials.eu/ctis-public/view/2024-514744-91-00